EU clinical trial 2024-516372-14-00: SUPPRESS. Prophylactic frequent premature ventricular complexeS sUPPression on left ventriculaR function impairmEnt in aSymptomatic patientS
Protocol code: APHP180618
Sponsor: Assistance Publique Hopitaux De Paris (Hospital/Clinic/Other health care facility). Phase: Phase III and phase IV (Integrated). Countries: France (ongoing, recruiting).
Therapeutic area(s): Diseases [C] - Cardiovascular Diseases [C14]
Gender: Female, Male. Age: 18-64 years, 65+ years. Enrolment: 298.
Status: Ongoing, recruiting. Start date (EU): 2025-01-13. Decision date: 2024-09-18. Results received: No. Last updated: 2024-09-18.

Condition(s): Asymptomatic Patients with frequent PVCs and normal LVEF
Product: VERAPAMIL, NEBIVOLOL, PROPAFENONE, BISOPROLOL, AMIODARONE, FLECAINIDE, SOTALOL, DILTIAZEM

Primary endpoint: the development of LV dysfunction (PVC‐iCMP) defined as a 15% relative LVEF decrease (and/or a LVEF <50%) within 2 years following randomization, on cardiac magnetic resonance imaging (cMRI) (or transthoracic echocardiography (TTE) when not possible).
Endpoint(s): Other efficacy endpoints, Mean PVC burden during the whole follow‐up (M6, M12, M18 and at M24), Percentage of patients with a PVC burden <10% during the second year following randomization (and time to obtain a PVC burden <10%), LVEF variation (from baseline to M24), LV volumes variation (end‐diastolic and systolic volumes) from baseline to M24, Global Longitudinal Strain (GLS) variation from baseline to M24, Cumulative incidence of patients decreasing their GLS >15% from baseline to M24, Nt‐ProBNP relative variation from baseline to M24, Exercise capacity on treadmill (Watts, Mets, MVO2) and NYHA at baseline and M24, Quality of life will be assessed with SF‐36 (Short Form 36) scale administered for both arms at inclusion, at M12 and at M24., Safety endpoints: • Death from any cause • Cardiovascular cause of death • Hospitalization for an adverse event • The nature, frequency, severity and outcome of adverse events (AE) and serious adverse events (SAE) within follow‐up (that may be linked or not to antiarrhythmic drugs (AAD) or ablation procedure)

Source: https://euclinicaltrials.eu/ctis-public/view/2024-516372-14-00